EU clinical trial 2025-523409-13-00: A study to find how safe different doses of LFD-200 are and how it works in both healthy people and people with moderate to severe rheumatoid arthritis
Protocol code: LFD200A11
Sponsor: Lifordi Immunotherapeutics Inc. (Pharmaceutical company). Phase: Human Pharmacology (Phase I)- First administration to humans. Countries: Poland (authorised, recruitment pending).
Therapeutic area(s): Diseases [C] - Immune System Diseases [C20]
Gender: Female, Male. Age: 18-64 years, 65+ years. Enrolment: 40.
Status: Authorised, recruitment pending. Decision date: 2026-01-30. Results received: No. Last updated: 2026-01-30.

Condition(s): Moderate to Severe Rheumatoid Arthritis

Source: https://euclinicaltrials.eu/ctis-public/view/2025-523409-13-00